EU clinical trial 2024-512658-41-00: Peritoneal Ultrafiltration in Cardio Renal Syndrome to Prevent Heart Failure Exacerbation (PURE)
Protocol code: CQ-001-19
Sponsor: Iperboreal Pharma S.r.l. (Pharmaceutical company). Phase: Phase II and Phase III (Integrated). Countries: Italy (ongoing, recruiting).
Therapeutic area(s): Diseases [C] - Cardiovascular Diseases [C14]
Gender: Female, Male. Age: 18-64 years, 65+ years. Enrolment: 84.
Status: Ongoing, recruiting. Start date (EU): 2024-03-06. Decision date: 2024-05-15. Results received: No. Last updated: 2026-04-23.

Condition(s): Congestive Heart Failure
Product: PolyCore

Primary endpoint: Composite end point of 1) patient mortality; 2) hospitalization for cardiovascular causes, including the need for i.v. diuretics and/or hemofiltration; 3) The need of increasing of ≥30% the initial daily dose of loop diuretic; 4) Worsening renal function defined as eGRF ˂10 ml/min/1,73 m2
Endpoint(s): 6 min Walking distance (V1, V5, V8, V9), Quality of life by Kansas City Cardiomyopathy Questionnaire (V1, V5, V8, V9), Decrease in NT pro-BNT level of >=25% or BNP of >=40% (V1, V5, V8, V9), Change in NYHA class (V1, V5, V8, V9, Long term FU), Hospitalization for intra-venous therapy with loop diuretic, Requiring other methods of treatment [i.e. PUF or hemodialysis], Hospitalization for all causes, Worsening of renal function defined as % of change of GFR (V1, V3, V4, V5, V6, V7, V8, V9, Long term), Change in the cumulative daily dosage of loop diuretic, Use of hospital resources for cardiovascular causes, The number of patients requiring hospitalization for intra-venous therapy with loop diuretic, The number of patients increasing of ≥30% an equivalent of the daily dose of oral furosemide, Safety (adverse events, vital signs, physical examination, ECG, laboratory parameters)

Source: https://euclinicaltrials.eu/ctis-public/view/2024-512658-41-00